EU clinical trial 2023-507510-27-00: Randomized, single blind, non-inferiority study on the speed of action of lysin ibuprofen suspension vs ibuprofen suspension in the treatment of acute pain in children (SAPed).
Protocol code: SAPed
Sponsor: Dicofarm S.p.A. (Pharmaceutical company). Phase: Therapeutic use (Phase IV). Countries: Italy (ended).
Therapeutic area(s): Not possible to specify
Gender: Female, Male. Age: 0-17 years. Enrolment: 192.
Status: Ended. End date (EU): 2024-09-04. Decision date: 2024-01-11. Results received: No. Last updated: 2024-01-11.

Condition(s): Acute pain in pediatric age
Product: ALGIDRIN 20 mg/ml sospensione orale, Bambini, MOMENTKID bambini 100 mg/5 ml sospensione orale, NUROFEN FEBBRE E DOLORE Bambini 100mg/5ml sospensione orale gusto arancia senza zucchero

Primary endpoint: Non inferiority of speed of action of lysin ibuprofen suspension on pain intensity measured by validated agerelated scale (Wong-Baker Faces Pain scale and Numerical Rating Scale). The reduction of pain (abbreviated PAR, from pain relief) will be assessed at different time points on the difference in the values of the pain scales used. The main assessment is at five minutes timepoint.
Endpoint(s): 1. Evaluation of PAR general score after 10 , 20 and 30 minutes. 2. Evaluation of AEs/SAEs.

Source: https://euclinicaltrials.eu/ctis-public/view/2023-507510-27-00